EU clinical trial 2022-503063-15-00: Anti-BCMA chimeric antigen receptor (CARTemis-1) T-lymphocyte therapy in the treatment of patients with multiple myeloma in relapse after allogeneic transplant: EGFR expression as a control mechanism of treatment-derived complications
Protocol code: CARTemis-1
Sponsor: Fundacion Publica Andaluza para la Gestion de la Investigacion en Salud de Sevilla (FISEVI) (Laboratory/Research/Testing facility). Phase: Phase I and Phase II (Integrated)- First administration to humans. Countries: Spain (ongoing, recruiting).
Therapeutic area(s): Diseases [C] - Neoplasms [C04]
Gender: Female, Male. Age: 18-64 years, 65+ years. Enrolment: 25.
Status: Ongoing, recruiting. Start date (EU): 2025-09-22. Decision date: 2024-05-06. Results received: No. Last updated: 2026-04-27.

Condition(s): Multiple myeloma.
Product: DEXCHLORPHENIRAMINE, CYCLOPHOSPHAMIDE, TOCILIZUMAB, ALLOPURINOL, FLUDARABINE PHOSPHATE, CETUXIMAB, PARACETAMOL

Primary endpoint: Primary feasibility variable: Number of cases in which the manufacturing process is completed and HUVR-CARTemis-1 cells are infused., Safety variables: Maximum tolerated dose of HUVR-CARTemis-1 determined based on the incidence in different patient cohorts of the following toxicities: Rate of patients developing cytokine release syndrome and/or neurological toxicity and/or macrophage activation. Rate of patients developing graft-versus-recipient disease - Patients developing grade 3-4 toxicities that do not respond to standard treatment. Presence of infusional reactions. -Presence of SAEs, SUSARs throughout the study., Safety variables: Tumour lysis syndrome.
Endpoint(s): Determine cytopenias developed during the first 90 days or prolonged, Duration of response in responder patients, Overall response rate, Time to complete remission, Time to best response, Rate of bone marrow-negative EMR, Extramedullary disease response rate, Progression-free survival, HUVR-CARTemis-1 administration and disease progression or death, Overall survival and patient death, Persistence of HUVR-CARTemis-1 in peripheral blood and marrow, Evaluation of the biological characteristics of HUVR-CARTemis-1, BCMA expression, Levels of soluble BCMA

Source: https://euclinicaltrials.eu/ctis-public/view/2022-503063-15-00